EU clinical trial 2024-514296-17-00: A study to test how BI 3031185 is tolerated by people with borderline personality disorder or attention-deficit/hyperactivity disorder.
Protocol code: 1516-0003
Sponsor: Boehringer Ingelheim International GmbH (Pharmaceutical company). Phase: Human Pharmacology (Phase I)- Other. Countries: Germany (ended).
Therapeutic area(s): Psychiatry and Psychology [F] - Mental Disorders [F03]
Gender: Female, Male. Age: 18-64 years. Enrolment: 68.
Status: Ended. Start date (EU): 2025-08-05. End date (EU): 2026-08-06. Decision date: 2025-03-13. Results received: No. Last updated: 2026-06-09.

Condition(s): Attention deficit hyperactivity disorder, Borderline personality disorder

Source: https://euclinicaltrials.eu/ctis-public/view/2024-514296-17-00